EU clinical trial 2023-507561-26-00: A 4-Week, Phase II, Multicenter, Randomized, Double-Masked, Vehicle-Controlled, Parallel Group Study With 4 Weeks of Follow-Up to Evaluate Safety and Efficacy of a new formulation of Recombinant Human Nerve Growth Factor (rhNGF) Eye Drop Solution at two different Concentrations in patients with Dry Eye Disease (REDUCO study)
Protocol code: NGF0123
Sponsor: Dompe' Farmaceutici S.p.A. (Pharmaceutical company). Phase: Therapeutic exploratory (Phase II). Countries: Italy (ended).
Therapeutic area(s): Diseases [C] - Eye Diseases [C11]
Gender: Female, Male. Age: 18-64 years, 65+ years. Enrolment: 126.
Status: Ended. Start date (EU): 2024-05-17. End date (EU): 2024-11-22. End date: 2024-12-04. Decision date: 2024-04-12. Results received: Yes. Last updated: 2024-08-02.

Condition(s): Dry Eye
Product: rhNGF New Lyo Formulation, OXYBUPROCAINE, SODIUM CHLORIDE, rhNGF New Lyo Formulation, The placebo consists of a lyophilized product packaged in 2R siliconized glass class I vials closed with a stopper and a flip off cap and administered after reconstitution with 2mL of diluent contained into a 2R glass class I vials closed with a stopper and a flip off cap. The diluent consists of DMSO, Sesame Extract 98%, Kollifor HS 0.15%, Sodium Chloride, Water For Injection. The product is reconstituted using an adapter and a syringe and administered using an adapter and a pipette., The placebo consists of a lyophilized product packaged in 2R siliconized glass class I vials closed with a stopper and a flip off cap and administered after reconstitution with 1mL of diluent contained into a 2R glass class I vials closed with a stopper and a flip off cap. The diluent consists of DMSO, Sesame Extract 98%, Kollifor HS 0.15%, Sodium Chloride, Water For Injection. The product is reconstituted using an adapter and a syringe and administered using an adapter and a pipette. The product is reconstituted using an adapter and a syringe and administered using an adapter and a pipette., TROPICAMIDE

Primary endpoint: The primary efficacy endpoint is the mean change from baseline to Week 8 in symptoms of dry eye assessed by SANDE Global Score [Time Frame: week 8 (V5)].
Endpoint(s): ● Proportion of patients improving to Schirmer-I test without anesthesia ≥10mm/5min in the Study Eye [Time Frame: at week 4 (V4)], ● Mean change from baseline in Schirmer-I score without anesthesia in the Study Eye [Time frame: at week 4 (V4)], ● Mean change from baseline in total corneal fluorescein staining (NEI scale) in the Study Eye as assessed by the investigator [Time Frame: at week 4 (V4)], ● Mean change from baseline in Schirmer-I score without anesthesia in the Study Eye [Time frame: at week 8 (V5)], ● Proportion of patients improving to Schirmer-I test without anesthesia ≥10mm/5min in the Study Eye [Time Frame: at week 8 (V5)], ● Mean change from baseline in fluorescein tear break-up time (fTBUT)- in the Study Eye [Time Frame: at weeks 4 (V4) and 8 (V5)], ● Mean change from baseline in symptoms questionnaire (SANDE) scores for severity and frequency [Time Frame: at weeks 4 (V4) and 8 (V5)], ● Mean change from baseline in symptoms of dry eye assessed by SANDE Global Score [Time Frame: at week 4 (V4)], ● Mean change from baseline in total conjunctival lissamine green staining (NEI scale) in the Study eye as assessed by the investigator [Time Frame: at week 4 (V4)], ● Mean change from baseline in ocular pain assessed by the OPAS questionnaire’s pain scale [Time Frame: at weeks 4 (V4) and 8 (V5)], ● Mean change from baseline in best corrected distance visual acuity (BCDVA) [Time Frame: at weeks 4 (V4) and 8 (V5)], ● Mean change from baseline of QoL assessed by the OPAS questionnaire’s QoL score [Time Frame: at weeks 4 (V4) and 8 (V5)], ● Safety will be monitored by the incidence and frequency of Treatment-Emergent Adverse Events (TEAEs) assessed throughout the study including Run-In period., ● Mean change from baseline in corneal endothelial cell density in both eyes performed at sites that have a specular microscope [Time Frame: at week 8 (V5)], ● Change from baseline in the proportion of patients with vitritis, retinal or vitreal hemorrhages, increase in cup-to-disc ratio, retinal or posterior vitreal detachment, retinal tears, or maculopathy on dilated fundus exam (DFE) in both eyes [Time Frame: at week 8 (V5)], ● Mean change from baseline in bulbar conjunctival redness in both eyes (VBR 10 score) [Time Frame: at weeks 4 (V4) and 8 (V5)], ● Treatment discontinuation rate due to tolerability issues.

Source: https://euclinicaltrials.eu/ctis-public/view/2023-507561-26-00